EU clinical trial 2024-519597-39-00: Efficacy of melatonin, low-dose quetiapine, or placebo in adolescents with psychiatric disorders and comorbid insomnia: a randomized clinical trial
Sponsor: Psykiatrisk Center Kobenhavn (Hospital/Clinic/Other health care facility). Phase: Phase II and Phase III (Integrated). Countries: Denmark (ongoing, recruiting).
Therapeutic area(s): Psychiatry and Psychology [F] - Mental Disorders [F03]
Gender: Female, Male. Age: 0-17 years. Enrolment: 255.
Status: Ongoing, recruiting. Start date (EU): 2025-08-18. Decision date: 2025-04-14. Results received: No. Last updated: 2025-04-14.

Condition(s): Psychiatric disorder (ICD-10 F20-F69, F84, F90-F95) and insomnia
Product: Melatonin Orifarm 3 mg filmdragerade tabletter, Quetiapin Sandoz 25 mg filmdrasjerte tabletter, Starch and Lactose containing gelatine capsules

Primary endpoint: Insomnia severity using the Insomnia Severity Index (ISI)
Endpoint(s): Clinical global impression (CGI), Subjective sleep quality using the Pittsburgh Sleep Quality Index (PSQI), Psychosocial functioning using the Personal and Social Performance Scale (PSP), Patient-reported subjective well-being using the WHO-5 well-being index, Rest-sleep-activity cycles and physiological variables

Source: https://euclinicaltrials.eu/ctis-public/view/2024-519597-39-00